EU clinical trial 2023-508292-37-00: A randomized double-blind, placebo-controlled, multicenter trial assessing the impact of lipoprotein (a) lowering with pelacarsen (TQJ230) on major cardiovascular events in patients with established cardiovascular disease
Protocol code: CTQJ230A12301
Sponsor: Novartis Pharma AG (Pharmaceutical company). Phase: Therapeutic confirmatory (Phase III). Countries: Hungary (ended), Czechia (ended), Sweden (ended), Italy (ended), Netherlands (ended), Germany (ongoing, recruitment ended), Slovakia (ended), Portugal (ended), Romania (ended), Denmark (ended), Norway (ended), Poland (ended), Slovenia (ended), Bulgaria (ended), Spain (ended), Belgium (ended), Greece (ended), Austria (ended), France (ended), Iceland (ended).
Therapeutic area(s): Diseases [C] - Cardiovascular Diseases [C14]
Gender: Female, Male. Age: 18-64 years, 65+ years. Enrolment: 4117.
Start date (EU): 2020-03-06. Decision date: 2024-05-03. Results received: No. Last updated: 2026-08-04.
Decision dates by country: NO: 2024-05-03, DE: 2024-05-03, IT: 2024-05-03, BE: 2024-05-08, IS: 2024-06-19, RO: 2024-05-08, DK: 2024-05-03, GR: 2024-06-17, PL: 2024-05-06, HU: 2024-05-03, SK: 2024-05-03, NL: 2024-05-03, PT: 2024-05-03, SI: 2024-05-09, SE: 2024-05-07, ES: 2024-05-07, CZ: 2024-05-06, BG: 2024-05-30, AT: 2024-05-21, FR: 2024-05-31

Condition(s): Cardiovascular Disease
Product: Placebo to TQJ230 80 mg/0.8 mL Solution for injection in pre-filled syringe with needle safety device, TQJ230

Primary endpoint: Time to the first occurrence of CEC confirmed expanded MACE (cardiovascular death, nonfatal MI, non-fatal stroke and urgent coronary re-vascularization requiring hospitalization) in a population of patients with elevated Lp(a) ≥ 70 mg/dL, Time to the first occurrence of CEC confirmed expanded MACE (cardiovascular death, non-fatal MI, non-fatal stroke and urgent coronary re-vascularization requiring hospitalization) in a subpopulation of patients with elevated Lp(a) ≥ 90 mg/dL
Endpoint(s): Time to the first occurrence of the CEC confirmed composite endpoint of MACE (CV death, non-fatal MI, and non-fatal stroke), Time to the first occurrence of the CEC confirmed composite endpoint of CHD: CHD death, non-fatal MI, urgent coronary revascularization requiring hospitalization, Change in Lp(a) in the log scale from baseline at 1 year, Time to CEC confirmed all-cause death

Source: https://euclinicaltrials.eu/ctis-public/view/2023-508292-37-00